EU clinical trial 2024-517529-26-00: A Phase 3 Randomized, Double-Blind, Placebo-Controlled Study to Evaluate the Efficacy and Safety of DNTH103 in Adults with Chronic Inflammatory Demyelinating Polyneuropathy (CAPTIVATE)
Protocol code: DNTH103-CIDP-301
Sponsor: Dianthus Therapeutics Inc. (Laboratory/Research/Testing facility). Phase: Therapeutic confirmatory (Phase III). Countries: Croatia (authorised, recruitment pending), Belgium (ongoing, recruiting), France (ongoing, recruiting), Italy (ongoing, recruiting), Germany (ongoing, recruiting), Spain (ongoing, recruiting), Poland (ongoing, recruiting), Latvia (authorised, recruitment pending), Romania (authorised, recruiting), Denmark (ongoing, recruiting), Bulgaria (ongoing, recruiting), Netherlands (authorised, recruiting).
Therapeutic area(s): Diseases [C] - Immune System Diseases [C20]
Gender: Female, Male. Age: 18-64 years, 65+ years. Enrolment: 147.
Start date (EU): 2025-08-04. Decision date: 2025-06-10. Results received: No. Last updated: 2026-08-07.
Decision dates by country: BG: 2025-07-25, HR: 2025-06-13, FR: 2025-06-12, LV: 2025-06-12, RO: 2025-06-16, ES: 2025-06-16, NL: 2025-06-20, PL: 2025-06-16, DE: 2025-06-13, DK: 2025-06-11, BE: 2025-06-10, IT: 2025-06-12

Condition(s): Chronic Inflammatory Demyelinating Polyneuropathy
Product: Placebo matching DNTH103, DNTH103

Primary endpoint: Part B: Time from first dose to relapse as assessed by the adjusted Inflammatory Neuropathy Cause and Treatment (INCAT)
Endpoint(s): Part B: Time to decrease of ≥ 4 points (centile metric) in Inflammatory Rasch-built Overall Disability Scale (I-RODS) score, Part B: Time to a decrease of ≥ 8 kilopascal (kPa) in grip strength in the dominant hand, Part B: Proportion of participants who relapse as assessed by the adjusted INCAT, Parts A and B: Change in I-RODS score (centile metric), Parts A and B: Change in grip strength in the dominant hand, Parts A and B: Change in adjusted INCAT Score, Parts A and B: Change in grip strength in the nondominant hand, Parts A and B: Change in Medical Research Council Sum Score (MRC-SS), Part A: Proportion of participants with a confirmed response to claseprubart as assessed by the adjusted INCAT, Parts A and B: Change in Euro-Quality of Life Visual Analogue Scale (EQ-VAS), Parts A and B: Change in Fatigue Severity Scale (FSS), Parts A and B and OLE: Change in adjusted INCAT score, Part B and OLE: Proportion of participants with a confirmed relapse as assessed by the adjusted INCAT, Parts A, B, OLE, and Safety Follow-up: Incidence of treatment-emergent adverse events (TEAEs) and treatment-emergent serious adverse events (SAEs), Parts A, B, OLE, and Safety Follow-up: Serum concentrations of claseprubart, Parts A, B, and OLE: Change from baseline in complement total blood test (CH50), Parts A, B, OLE, and Safety Follow-up: Incidence and titer of antidrug antibodies (ADAs)

Source: https://euclinicaltrials.eu/ctis-public/view/2024-517529-26-00